EU clinical trial 2023-507256-76-00: An open-label randomized trial COmparing staNdard of care versus Treat to target with telemonitoRing and patient education in patients with ulcerative cOlitis initiating adalimumab : The CONTROL trial
Sponsor: Groupe D'etude Therapeutique Des Affections Inflammatoires Du Tube Digestif (Laboratory/Research/Testing facility). Phase: Therapeutic use (Phase IV). Countries: France (ongoing, recruiting).
Therapeutic area(s): Diseases [C] - Digestive System Diseases [C06]
Gender: Female, Male. Age: 18-64 years, 65+ years. Enrolment: 238.
Status: Ongoing, recruiting. Start date (EU): 2020-01-14. Decision date: 2024-05-28. Results received: No. Last updated: 2024-11-08.

Condition(s): Ulcerative colitis
Product: Humira 40 mg solution for injection in pre-filled syringe

Primary endpoint: At week 48 success defined by Endoscopic remission defined by an endoscopic Mayo score 0
Endpoint(s): Clinical remission (Clinical remission is defined as a total Mayo score ≤ 2 points, with no individual sub score > 1, and a Mayo endoscopy sub score of 0 or 1), Remission without steroids, Endoscopic healing rate with Mayo score 0 or 1, UCEIS score, Histological healing (Nancy score), Remission rate and remission rate without steroids at study visits and W48, Quality of life evolution (evaluate visit 0 vs W14, W26, W38 and W48), Patients satisfaction, Continuous response, Safety and tolerability, Anti-TNF pharmacokinetics, Number of visits in trial, Number of UC related hospitalizations, Number of colectomies, Treatment compliance (questionnaire), Patient adhesion (questionnaire), Medico-economic analysis

Source: https://euclinicaltrials.eu/ctis-public/view/2023-507256-76-00